EU clinical trial 2024-516132-10-00: A randomized, double-blind, parallel-group, multicentre, phase II study to compare the efficacy and tolerability of fulvestrant (FaslodexTM) 500mg with placebo and fulvestrant (FaslodexTM) 500mg in combination with PD-0332991 (Palbociclib) as first line treatment for postmenopausal women with hormone receptor-positive metastatic breast cancer, who have completed at least 5 years of adjuvant endocrine therapy and remained disease free for more than 12 months following its completion or have de novo metastatic disease. "The FLIPPER Study"
Protocol code: GEICAM/2014-12
Sponsor: Fundacion Grupo Espanol De Investigacion En Cancer De Mama (Patient organisation/association). Phase: Therapeutic exploratory (Phase II). Countries: Spain (ended), Ireland (ended).
Therapeutic area(s): Diseases [C] - Neoplasms [C04]
Gender: Female. Age: 18-64 years, 65+ years. Enrolment: 189.
Status: Ended. Start date (EU): 2016-02-05. End date (EU): 2025-12-10. Decision date: 2024-10-23. Results received: No. Last updated: 2025-09-26.
Decision dates by country: IE: 2024-10-25, ES: 2024-10-23

Condition(s): Metastatic breast cancer
Product: Faslodex 250 mg solution for injection., PALBOCICLIB, PALBOCICLIB, PALBOCICLIB, PALBOCICLIB, PALBOCICLIB, PALBOCICLIB

Primary endpoint: Rate of patients free of progression at 1 year assessed according to Response Evaluation Criteria in Solid Tumours (RECIST) version 1.1 by the investigator.
Endpoint(s): The following efficacy endpoints will be measured: o Progression-Free Survival (PFS) assessed according to RECIST version 1.1 by the investigator. o Objective Response Rate (ORR): Complete Response (CR) plus Partial Response (PR) according to RECIST version 1.1. o Clinical Benefit Rate (CBR): CR plus PR plus stable disease (SD) lasting ≥24 weeks (+/-2 weeks) according to RECIST version 1.1. o Overall Survival (OS). o 1-year and 2-year survival probabilities., Safety will be assessed by standard clinical and laboratory tests (haematology, serum chemistry). AEs grade will be defined by the NCI CTCAE (National Cancer Institute Common Terminology Criteria for Adverse Events) version 4.0., Changes (mean score) and time to deterioration on EORTC QLQ-C30 Global Health Status/QoL and Physical Function and EORTC QLQ-BR23 Breast Module from baseline.

Source: https://euclinicaltrials.eu/ctis-public/view/2024-516132-10-00